EU clinical trial 2024-517061-16-01: An Open Label Clinical Trial to Evaluate the Efficacy and Safety of PRAX-628 in Adult Patients with Focal Onset or Primary Generalized Tonic-Clonic Seizures
Protocol code: PRAX-628-212
Sponsor: Praxis Precision Medicines Inc. (Pharmaceutical company). Phase: Therapeutic exploratory (Phase II). Countries: Germany (ended), Spain (ended).
Therapeutic area(s): Diseases [C] - Nervous System Diseases [C10]
Gender: Female, Male. Age: 18-64 years, 65+ years. Enrolment: 35.
Status: Ended. Start date (EU): 2025-02-27. End date (EU): 2025-11-07. End date: 2026-02-04. Decision date: 2025-02-14. Results received: No. Last updated: 2025-10-27.
Decision dates by country: ES: 2025-03-27, DE: 2025-02-14

Condition(s): Focal onset seizures or primary generalized tonic-clonic seizures
Product: PRAX-628

Primary endpoint: Median percent change in monthly (28 days) seizure frequency from the Screening/Observation Period to the Treatment Period for PRAX-628
Endpoint(s): Number of days after the first administration of PRAX-628 to reach the same number or higher of monthly seizures from the Screening/Observation Period to the Treatment Period, Impact of PRAX-628 on PGI-S and CGI-S, Incidence and severity of TEAEs, including discontinuation of study drug due to TEAEs, Changes in vital signs measurements, Changes in clinical laboratory results, Changes in ECG parameters, Changes in suicidality, as assessed by C-SSRS, Proportion of participants experiencing a ≥50% reduction in monthly (28 days) seizure frequency from the Screening/Observation Period to the Treatment Period (Responder Rate) for PRAX-628, Proportion of participants experiencing seizure freedom, 100% reduction in monthly (28 days) seizure frequency from the Screening/Observation Period to the Treatment Period for PRAX-628

Source: https://euclinicaltrials.eu/ctis-public/view/2024-517061-16-01